EU clinical trial 2023-507334-24-00: MUNC13.4 - A phase I/II Open Label non randomized study, monocentric, single arm, evaluating Safety and Efficacy of Gene Therapy of FHL 3 caused by mutations in the human UNC13D gene by transplantation of a single dose of autologous CD34+ cells transduced ex vivo with the UNC13D LV vector expressing the UNC13D cDNA
Protocol code: APHP240201
Sponsor: Assistance Publique Hopitaux De Paris (Hospital/Clinic/Other health care facility). Phase: Human Pharmacology (Phase I)- First administration to humans. Countries: France (authorised, recruitment pending).
Therapeutic area(s): Diseases [C] - Immune System Diseases [C20]
Gender: Female, Male. Age: 0-17 years. Enrolment: 5.
Status: Authorised, recruitment pending. Decision date: 2024-10-18. Results received: No. Last updated: 2026-08-04.

Condition(s): Familial Hemophagocytic Lymphohistiocytosis (FHL)
Product: MUNC13.4-CD34 suspension, MUNC13.4-T3 suspension

Primary endpoint: 1. Incidence of Transplantation Related Mortality (TRM) up to M3 post treatment., 2. Frequency and severity of clinical AEs and laboratory parameters throughout the whole period of the research. Adverse event will be measured using CTCAE., 3. Incidence of clinically detectable malignancy and/or abnormal clonal dominance assessed as related to study treatment M12 (Bone marrow analysis and VISA) Detection of Replication –Competent Lentivirus (RCL) at M12.
Endpoint(s): 1. Characterized the engraftment of DPs through hematopoietic reconstitution after IV infusion of MUNC-CD34: a. Neutrophil and platelet recovery (ANC> 500/µl, Platelets > 20.000/µl on two consecutive days without transfusion), 2. Assess the initial efficacy of treatment : a. The Persistent HLH remission evaluated by the Disease-free survival (DFS) at M6. b. VCN in PBMC > 0.2 at M6., 3. Assess the long-term safety and efficacy. a. The Persistant HLH remission evaluated by the Disease-free survival (DFS) at M24 b. VCN in PBMC > 0.2 at M24. c. Correction of degranulation function in T-CD3 at M24., 4. Estimate of the cost of the complete procedure, from mobilisation to transplant and estimate of the 24 months total cost.

Source: https://euclinicaltrials.eu/ctis-public/view/2023-507334-24-00